EU clinical trial 2023-507312-13-00: A Phase 3 Study Comparing Daratumumab, VELCADE (bortezomib), Lenalidomide, and Dexamethasone (D-VRd) with VELCADE, Lenalidomide, and Dexamethasone (VRd) in Subjects with Untreated Multiple Myeloma and for Whom Hematopoietic Stem Cell Transplant is Not Planned as Initial Therapy
Protocol code: 54767414MMY3019
Sponsor: Janssen - Cilag International (Pharmaceutical company). Phase: Therapeutic confirmatory (Phase III). Countries: Spain (ended), Netherlands (ended), France (ended), Germany (ended), Czechia (ended), Poland (ended).
Therapeutic area(s): Diseases [C] - Neoplasms [C04]
Gender: Female, Male. Age: 18-64 years, 65+ years. Enrolment: 157.
Status: Ended. Start date (EU): 2018-11-15. End date (EU): 2025-10-30. End date: 2026-04-21. Decision date: 2023-11-17. Results received: No. Last updated: 2025-05-05.
Decision dates by country: CZ: 2024-01-18, FR: 2023-11-30, DE: 2023-11-22, ES: 2023-11-17, NL: 2023-11-17, PL: 2024-01-26

Condition(s): Multiple Myeloma
Product: Revlimid 20 mg hard capsules, Dexamethason 4 mg JENAPHARM®, VELCADE 3.5 mg powder for solution for injection, DEXAMETHASONE, Revlimid 25 mg hard capsules, Revlimid 5 mg hard capsules, Revlimid 15 mg hard capsules, Revlimid 15 mg hard capsules, Revlimid 5 mg hard capsules, Revlimid 10 mg hard capsules, Revlimid 10 mg hard capsules, DARZALEX 1800 mg solution for injection

Primary endpoint: Overall MRD negativity rate, which is defined as the proportion of subjects who have achieved MRD negative status (at 10^-5) by bone marrow aspirate after randomization and prior to progressive disease (PD) or subsequent anti myeloma therapy. Subjects who have achieved MRD negative status on or after PD or after the switch to subsequent anti-myeloma therapy before PD, will not be considered MRD negative in the primary endpoint analysis

Source: https://euclinicaltrials.eu/ctis-public/view/2023-507312-13-00